EU clinical trial 2024-519044-32-00: A Master Protocol Phase I/II Study to Investigate Biomarker‑Guided Novel Anticancer Agent(s) as Monotherapy or Combination Therapy for the Treatment of Participants with Advanced/Recurrent Ovarian Cancer (Ovarian Platform)
Protocol code: D9724C00001
Sponsor: AstraZeneca AB (Pharmaceutical company). Phase: Phase I and Phase II (Integrated)- Other. Countries: Italy (ended), Spain (ended).
Therapeutic area(s): Diseases [C] - Neoplasms [C04]
Gender: Female. Age: 18-64 years, 65+ years. Enrolment: 16.
Status: Ended. Start date (EU): 2025-08-06. End date (EU): 2025-11-25. End date: 2025-11-26. Decision date: 2025-07-07. Results received: No. Last updated: 2025-11-12.
Decision dates by country: ES: 2025-07-08, IT: 2025-07-07

Condition(s): Advanced/Recurrent Ovarian cancer
Product: Saruparib

Primary endpoint: Safety endpoints will include, but are not limited to, the following: - TEAEs, SAEs, AEs leading to dose modifications, procedure-related AEs. -Changes from baseline in vital signs, clinical laboratory assessments, ECGs, ECOG PS, and physical examinations.
Endpoint(s): The primary measure of interest is the estimate of ORR prior to IDS. Confirmation of response is not required., The measure of interest is the estimate of confirmed CA125 response rate prior to IDS., Plasma concentrations of saruparib and its metabolite(s) if applicable. Report plasma PK parameters, including but not limited to AUC, Cmax and tmax as data allow, of saruparib after single dose and/or multiple doses administration.

Source: https://euclinicaltrials.eu/ctis-public/view/2024-519044-32-00